EU clinical trial 2024-515185-13-00: AN OPEN-LABEL EXTENSION (OLE) PHASE 3 TRIAL TO ASSESS THE SAFETY OF INTRAVITREAL ADMINISTRATION OF AVACINCAPTAD PEGOL (COMPLEMENT C5 INHIBITOR) IN PATIENTS WITH GEOGRAPHIC ATROPHY WHO PREVIOUSLY COMPLETED PHASE 3 STUDY ISEE2008 (GATHER2)
Protocol code: ISEE2009
Sponsor: Astellas Pharma Global Development Inc. (Pharmaceutical company). Phase: Therapeutic confirmatory (Phase III). Countries: Hungary (ended), Belgium (ended), France (ended), Austria (ended), Latvia (ended), Italy (ended), Spain (ended), Czechia (ended), Germany (ended), Croatia (ended).
Therapeutic area(s): Diseases [C] - Eye Diseases [C11]
Gender: Female, Male. Age: 18-64 years, 65+ years. Enrolment: 126.
Status: Ended. Start date (EU): 2022-12-21. End date (EU): 2025-04-10. End date: 2025-04-11. Decision date: 2024-10-09. Results received: Yes. Last updated: 2025-03-21.
Decision dates by country: BE: 2024-10-09, HR: 2024-10-14, CZ: 2024-10-11, HU: 2024-10-11, LV: 2024-10-14, ES: 2024-10-10, FR: 2024-10-09, AT: 2024-10-14, DE: 2024-10-11, IT: 2024-10-14

Condition(s): geographic atrophy
Product: Avacincaptad pegol, FLUORESCEIN

Primary endpoint: AEs
Endpoint(s): Immunogenicity, Pharmacokinetics

Source: https://euclinicaltrials.eu/ctis-public/view/2024-515185-13-00